EU clinical trial 2025-522606-20-00: A randomised, open label, three periods, three-treatment crossover study to evaluate the pharmacokinetics of alendronic acid oral formulations after single dose administration in healthy volunteers under fasted conditions: a pilot study
Protocol code: ALIQ-0225/PKP
Sponsor: Faes Farma S.A. (Pharmaceutical company). Phase: Human Pharmacology (Phase I)- Other. Countries: Czechia (ended).
Therapeutic area(s): Diseases [C] - Musculoskeletal Diseases [C05]
Gender: Female, Male. Age: 18-64 years. Enrolment: 24.
Status: Ended. Start date (EU): 2025-10-06. End date (EU): 2025-11-19. Decision date: 2025-09-08. Results received: No. Last updated: 2025-12-15.
Decision dates by country: CZ: 2025-09-12

Condition(s): Pharmacokinetic study in healthy volunteers under fasted conditions.

Source: https://euclinicaltrials.eu/ctis-public/view/2025-522606-20-00